EU clinical trial 2025-521556-35-00: A first-in-human, randomized, double-blind, placebo-controlled, three-part study assessing the safety, tolerability, pharmacokinetics and pharmacodynamics of BP1.15205 after single and repeated oral ascending doses, including the BP1.15205 effect on cardiac repolarization, as well as an exploratory assessment of the food effect on the pharmacokinetics of BP1.15205 in healthy participants
Protocol code: P24-06
Sponsor: Bioprojet Pharma (Pharmaceutical company). Phase: Human Pharmacology (Phase I)- First administration to humans. Countries: Belgium (ongoing, recruiting).
Therapeutic area(s): Diseases [C] - Nervous System Diseases [C10]
Gender: Female, Male. Age: 18-64 years. Enrolment: 178.
Status: Ongoing, recruiting. Start date (EU): 2025-10-28. Decision date: 2025-10-10. Results received: No. Last updated: 2026-07-21.

Condition(s): Narcolepsy

Source: https://euclinicaltrials.eu/ctis-public/view/2025-521556-35-00